EU clinical trial 2022-501374-19-00: A Multicenter, Open-label, Phase 2 Basket Study to Evaluate the Safety and Efficacy of MK‑2140 as a Monotherapy and in Combination in Participants with Aggressive and Indolent B-cell Malignancies (waveLINE-006).
Protocol code: MK-2140-006
Sponsor: Merck Sharp & Dohme LLC (Pharmaceutical company). Phase: Therapeutic exploratory (Phase II). Countries: Spain (ongoing, recruitment ended), Czechia (ongoing, recruitment ended), Portugal (ongoing, recruitment ended), Sweden (ongoing, recruitment ended), Poland (ongoing, recruitment ended), Estonia (ended), Italy (ongoing, recruitment ended), Ireland (ended), Germany (ended).
Therapeutic area(s): Diseases [C] - Neoplasms [C04]
Gender: Female, Male. Age: 18-64 years, 65+ years. Enrolment: 97.
Start date (EU): 2022-09-16. Decision date: 2024-02-07. Results received: No. Last updated: 2026-08-03.
Decision dates by country: EE: 2024-02-12, PL: 2024-02-08, IT: 2024-02-09, IE: 2024-02-07, CZ: 2024-02-08, DE: 2024-02-09, PT: 2024-02-08, SE: 2024-02-08, ES: 2024-02-07

Condition(s): Aggressive and Indolent B-cell Malignancies (mantle cell lymphoma; chronic lymphocytic leukemia; follicular lymphoma; Richter’s syndrome)
Product: Nemtabrutinib, Nemtabrutinib, Zilovertamab vedotin, Nemtabrutinib, Nemtabrutinib

Primary endpoint: Percentage of Participants with MCL (Cohort C), FL (Cohort D), and CLL with ≥1 Adverse Event (AE), Percentage of Participants with MCL (Cohort C), FL (Cohort D), and CLL who Discontinue from Study Therapy Due to AE, Percentage of Participants with MCL (Cohort C) who Experience a Dose-Limiting Toxicity (DLT), Objective Response Rate (ORR) per Lugano Response Criteria as Assessed by Blinded Independent Central Review (BICR) in Participants with MCL (Cohort A), RT (Cohort B), and FL (Cohort D), ORR per Lugano Response Criteria as Assessed by Investigator in Participants with MCL (Cohort C), ORR per International Workshop on Chronic Lymphocytic Leukemia (iwCLL) Criteria as Assessed by Investigator in Participants with CLL (Cohort D)
Endpoint(s): Duration of Response (DOR) per Lugano Response Criteria as Assessed by BICR in Participants with MCL (Cohort A), RT (Cohort B), and FL (Cohort D), DOR per Lugano Response Criteria as Assessed by Investigator in Participants with MCL (Cohort C), DOR per iwCLL Criteria as Assessed by Investigator in Participants with CLL (Cohort D), Percentage of Participants with ≥1 AE in Participants with MCL (Cohort A) and RT (Cohort B), Percentage of Participants Discontinuing from Study Therapy Due to AE in Participants with MCL (Cohort A) and RT (Cohort B)

Source: https://euclinicaltrials.eu/ctis-public/view/2022-501374-19-00